EU clinical trial 2022-502292-39-00: Does adding patient-controlled sedation with propofol during repair of obstetric perineal lacerations grade I and II improve patient experiences - a randomized control trial
Protocol code: PROP(ofol)
Sponsor: Region Oestergoetland (Hospital/Clinic/Other health care facility). Phase: Therapeutic confirmatory (Phase III). Countries: Sweden (ongoing, recruiting).
Therapeutic area(s): Diseases [C] - Female Urogenital Diseases and Pregnancy Complications [C13]; Analytical, Diagnostic and Therapeutic Techniques and Equipment [E] - Anesthesia and Analgesia [E03]
Gender: Female. Age: 18-64 years. Enrolment: 80.
Status: Ongoing, recruiting. Start date (EU): 2023-09-19. Decision date: 2023-03-29. Results received: No. Last updated: 2023-03-29.

Condition(s): Obstetric perineal lacerations
Product: ROPIVACAINE, LIDOCAINE, PROPOFOL, MEPIVACAINE, MEPIVACAINE, COMBINATIONS

Primary endpoint: Pain/discomfort (perprocedural)
Endpoint(s): Preprocedural anxiety, Time of repair the perineal laceration, Ability to have skin-to-skin contact with baby during perineal repair, Time until micturition after the perineal repair, Procedure feasibility, Amount of drugs used during perineal repair, Use of pain relief 24h postpartum, Patient experience after repair of perineal laceration 4 days postpartum, Need of pain-relieving within 24 h postpartum, Time to mobilisation of the patient, Time to micturition, Perprocedural anxiety

Source: https://euclinicaltrials.eu/ctis-public/view/2022-502292-39-00